EU clinical trial 2022-502524-41-00: A window-of-opportunity trial with high-dose vitamin C to enhance neoadjuvant immune checkpoint therapy in mismatch repair proficient colorectal cancer: the ALFEO pilot study
Sponsor: ASST Grande Ospedale Metropolitano Niguarda (Hospital/Clinic/Other health care facility). Phase: Therapeutic exploratory (Phase II). Countries: Italy (ongoing, recruitment ended).
Therapeutic area(s): Diseases [C] - Neoplasms [C04]
Gender: Female, Male. Age: 18-64 years, 65+ years. Enrolment: 24.
Status: Ongoing, recruitment ended. Start date (EU): 2023-05-02. Decision date: 2023-03-22. Results received: No. Last updated: 2023-03-22.

Condition(s): pMMR/MSS, Colon Cancer
Product: OPDIVO 10 mg/mL concentrate for solution for infusion., YERVOY 5 mg/ml concentrate for solution for infusion, ASCORBIC ACID

Primary endpoint: Pathological response rate
Endpoint(s): Adverse events rate

Source: https://euclinicaltrials.eu/ctis-public/view/2022-502524-41-00